EU clinical trial 2025-523261-25-00: A phase 2, single arm, open label, study on the safety and feasibility of Liver Isolated Oxaliplatin (LIOX) delivered via arterial access device for treatment of liver metastasis in colorectal cancer patients
Sponsor: UZ Leuven (Hospital/Clinic/Other health care facility). Phase: Therapeutic exploratory (Phase II). Countries: Belgium (authorised, recruitment pending).
Therapeutic area(s): Diseases [C] - Neoplasms [C04]; Analytical, Diagnostic and Therapeutic Techniques and Equipment [E] - Equipment and Supplies [E07]; Analytical, Diagnostic and Therapeutic Techniques and Equipment [E] - Therapeutics [E02]
Gender: Female, Male. Age: 18-64 years, 65+ years. Enrolment: 13.
Status: Authorised, recruitment pending. Decision date: 2026-02-27. Results received: No. Last updated: 2026-02-27.

Condition(s): colorectal cancer
Product: Oxaliplatin Accord Healthcare 5 mg/ml concentraat voor oplossing voor infusie

Primary endpoint: Incidence of adverse events
Endpoint(s): Liver Disease Control Rate

Source: https://euclinicaltrials.eu/ctis-public/view/2025-523261-25-00